EU clinical trial 2022-501327-25-00: Comparative Bioavailability of Lenvatinib 10 mg Capsules: A Two-Part, Single-Dose, Open-Label, Randomized, Six-Sequence, Three-Treatment, Three-Period, Crossover Pilot Study in Healthy Subjects Under Fasting and Fed Conditions.
Protocol code: BLCL-LEN-PIL01
Sponsor: Bluepharma Industria Farmaceutica S.A. (Pharmaceutical company). Phase: Human Pharmacology (Phase I)- Bioequivalence Study. Countries: Portugal (ended).
Therapeutic area(s): Diseases [C] - Neoplasms [C04]
Gender: Female, Male. Age: 18-64 years. Enrolment: 36.
Status: Ended. Start date (EU): 2023-05-13. End date (EU): 2023-07-10. Decision date: 2023-03-03. Results received: Yes. Last updated: 2023-07-10.

Condition(s): Advanced or recurrent endometrial carcinoma in adults who have disease progression on or following prior treatment with a platinum-containing therapy in any setting and are not candidates for curative surgery or radiation., Progressive, locally advanced or metastatic, differentiated (papillary/follicular/Hurthle cell) thyroid carcinoma, refractory to radioactive iodine in adults., Advanced or unresectable hepatocellular carcinoma in adults who have received no prior systemic therapy.
Product: Lenvatinib, Lenvatinib, LENVIMA 10 mg hard capsules

Primary endpoint: The following pharmacokinetic parameters will be estimated: maximum observed plasma concentration (Cmax); time of occurrence of Cmax (tmax); area under the plasma concentration versus time curve (AUC) from pre-dose (time zero) to 72 hours (AUC0-72); apparent terminal elimination rate constant (λz); and apparent terminal elimination half-life (t1/2).
Endpoint(s): Safety will be evaluated through the assessment of adverse events (AEs), ECG, vital signs and clinical laboratory tests.

Source: https://euclinicaltrials.eu/ctis-public/view/2022-501327-25-00